EU clinical trial 2023-508706-23-00: Phase 1/2a Trial to Evaluate the Safety, Tolerability and Efficacy of Nebulised RESP30X Nitric Oxide Formulations in Non-Cystic Fibrosis Bronchiectasis (NCFB) Patients with Pseudomonas Aeruginosa (Pa) or other Potentially Pathogenic Micro-organisms (PPMs).
Protocol code: RESP30X-001
Sponsor: Thirty Respiratory Limited (Pharmaceutical company). Phase: Phase I and Phase II (Integrated)- Other. Countries: Romania (ended), Bulgaria (ended), Poland (ended).
Therapeutic area(s): Diseases [C] - Respiratory Tract Diseases [C08]
Gender: Female, Male. Age: 18-64 years, 65+ years. Enrolment: 40.
Status: Ended. End date (EU): 2026-04-20. Decision date: 2024-04-18. Results received: No. Last updated: 2025-04-30.
Decision dates by country: RO: 2024-04-18, PL: 2024-04-22, BG: 2024-04-22

Condition(s): Non-Cystic Fibrosis Bronchiectasis with Pseudomonas Aeruginosa or other Potentially Pathogenic Micro-organisms
Product: RESP302, SALBUTAMOL, RESP303

Primary endpoint: 1. Incidence, intensity, causality, and seriousness of treatment-emergent adverse events (TEAEs)., 2. Changes in clinical laboratory values (haematology, clinical chemistry) at each time point., 3. Changes in vital signs (blood pressure, heart rate, temperature, respiratory rate) and oxygen saturation (SpO2) at each time point.
Endpoint(s): Plasma PK parameters peak serum concentration (Cmax), time to peak serum concentration (Tmax), area under the concentration-time curve from dosing (time 0) to time t (AUC0-t), area under the concentration-time curve from dosing (time 0) to end of dosing period (AUC0-tau), area under the concentration-time curve for total drug exposure from dosing (time 0) extrapolated to infinity (AUC0-inf), trough plasma concentration (Ctrough), and half-life (t1/2).

Source: https://euclinicaltrials.eu/ctis-public/view/2023-508706-23-00